EU clinical trial 2024-513527-17-00: A Phase 2, double-blind, randomized, placebo-controlled study assessing efficacy and safety of SAR441344, a CD40L-antagonist monoclonal antibody, in participants with relapsing multiple sclerosis.
Protocol code: ACT16877
Sponsor: Sanofi-Aventis Recherche & Developpement (Pharmaceutical company). Phase: Therapeutic exploratory (Phase II). Countries: Spain (ongoing, recruitment ended), Bulgaria (ongoing, recruitment ended), France (ongoing, recruitment ended), Germany (ongoing, recruitment ended), Czechia (ongoing, recruitment ended).
Therapeutic area(s): Diseases [C] - Nervous System Diseases [C10]
Gender: Female, Male. Age: 18-64 years. Enrolment: 72.
Status: Ongoing, recruitment ended. Start date (EU): 2021-06-07. Decision date: 2024-08-08. Results received: No. Last updated: 2026-05-27.
Decision dates by country: BG: 2024-08-08, FR: 2024-08-22, DE: 2024-08-16, CZ: 2024-08-13, ES: 2024-08-12

Condition(s): Multiple Sclerosis
Product: Matched Placebo for test product Frexalimab, Frexalimab

Primary endpoint: Number of new Gadolinium (Gd)-enhancing T1hyperintense (GdE T1) lesions at week 12
Endpoint(s): Total number of GdE T1 lesions at week 12, Adverse events (AEs) and serious adverse events (SAEs) until week 316, Antidrug antibodies (ADA) until week 316, Pharmacokinetic (PK) parameters: Cmax until week 316, PK parameter: tmax until week 316, PK parameter: AUC0-tau until week 316, PK parameter: t1/2z until week 316

Source: https://euclinicaltrials.eu/ctis-public/view/2024-513527-17-00